EU clinical trial 2025-521478-32-00: ANAKINRA IN THE TREATMENT OF PEDIATRIC ACUTE MYOCARDITIS. ANAPEM
Protocol code: APHP230825
Sponsor: Assistance Publique Hopitaux De Paris (Hospital/Clinic/Other health care facility). Phase: Therapeutic confirmatory (Phase III). Countries: France (authorised, recruitment pending).
Therapeutic area(s): Diseases [C] - Cardiovascular Diseases [C14]
Gender: Female, Male. Age: 0-17 years. Enrolment: 110.
Status: Authorised, recruitment pending. Decision date: 2025-09-04. Results received: No. Last updated: 2025-09-04.

Condition(s): PEDIATRIC ACUTE MYOCARDITIS
Product: SODIUM CHLORIDE, Kineret 100 mg/0.67 ml solution for injection in pre-filled syringe.

Primary endpoint: Proportion of children with recovered left ventricle ejection fraction (LVEF ≥ 50%) measured by echocardiography at 3 days after treatment initiation. Patients who die within the first 3 days after treatment initiation or patients who still require ECMO at 3 days after treatment initiation will be considered as a failure.
Endpoint(s): Proportion of children with recovered left ventricle ejection fraction (LVEF ≥ 50%) measured by echocardiography at 7 and 28 days after treatment initiation. Patients who die or undergo heart transplant within the first 7 and 28 days after treatment initiation respectively will be considered as a failure (i.e, LVEF < 50%). Patients who still require ECMO at 7 and 28 days after treatment initiation respectively will also be considered as failure (i.e., LVEF < 50%)., Time to recovery of normal left ventricular ejection fraction (LVEF ≥ 50%) within the first 3 days after treatment initiation 3- Proportion of children requiring ECMO within the first 3 days after treatment initiation, Proportion of children requiring ECMO within the first 3 days after treatment initiation, Proportion of children who undergo heart transplant within 6 months after treatment initiation, Time to all-cause death within 6 months after treatment initiation, Time to cardiovascular-related death within 6 months after treatment initiation, Proportion of children with drug-related side effects (hypersensitivity, neutropenia, drug-related liver enzymes elevation…), a- o NT proBNP at inclusion and at 24 hours, 48 hours, 72 hours following treatment initiation o Troponin T at inclusion and at 24 hours, 48 hours, 72 hours following treatment initiation o Proportion of children with ventricular tachycardia assessed by EKG at inclusion and at 24 hours, 48 hours, 72 hours following treatment initiation b- o NT proBNP at 7 days following treatment initiation o Troponin T at 7 days following treatment initiation o Proportion of children with ventricular tachyca

Source: https://euclinicaltrials.eu/ctis-public/view/2025-521478-32-00